EU clinical trial 2024-515352-20-00: IDIOME study: A single-arm phase II multicenter study of IDH1 (AG-120) inhibitor in patients with IDH1 mutated Myelodysplastic Syndrome
Protocol code: IDIOME Study
Sponsor: Groupe Francophone Des Myelodysplasies (Patient organisation/association). Phase: Therapeutic exploratory (Phase II). Countries: France (ended).
Therapeutic area(s): Diseases [C] - Hemic and Lymphatic Diseases [C15]
Gender: Female, Male. Age: 18-64 years, 65+ years. Enrolment: 48.
Status: Ended. Start date (EU): 2019-03-20. End date (EU): 2025-12-31. Decision date: 2024-08-02. Results received: Yes. Last updated: 2024-08-02.

Condition(s): myelodysplastic syndrome with IDH1 mutated
Product: Azacitidine 25 mg/ml powder for suspension for injection, AG-120/S95031 250mg film-coated tablet

Primary endpoint: Overall hematological response at 3 and 6 months (including CR, PR, stable disease with HI according to IWG 2006) for cohort A and B; SAFETY FOR COHORT C
Endpoint(s): Response duration and time response, Time to IPSS and R-IPSS progression, Rate and time to AML evolution, Overall survival, Cytogenetic and molecular response, Prognostic factors of response, including IPSS-R, IPSS-karyotype and somatic mutations, Evolution of IDH1 VAF on therapy, Adverse events and toxicity as measured by NCI CTCAE 5

Source: https://euclinicaltrials.eu/ctis-public/view/2024-515352-20-00